EU clinical trial 2024-518675-55-00: Towards a treatment for accelerated maturation in girls testing spiomet in a randomised placebo controlled, multicentre study.
Protocol code: MINI-SPIOMET
Sponsor: Hospital Universitari De Girona Doctor Josep Trueta (Hospital/Clinic/Other health care facility). Phase: Therapeutic exploratory (Phase II). Countries: Spain (ongoing, recruitment ended).
Therapeutic area(s): Phenomena and Processes [G] - Physiological processes [G07]
Gender: Female. Age: 0-17 years. Enrolment: 64.
Status: Ongoing, recruitment ended. Start date (EU): 2022-12-02. Decision date: 2024-10-28. Results received: No. Last updated: 2026-03-27.

Condition(s): Girls with advanced puberty and accelerated bone maturation. Polycystic Ovary Syndrome (PCOS)
Product: SPIOMET, Povidona K-30, celulosa microcristalina, croscarmelosa sódica, Polyglicol 4000, estearato de magnesio.

Primary endpoint: Bone age advancement 0-1 year (X-ray of hand and wrist of the left hand) using an automated method, BoneXpert (Visiana, Denmark).
Endpoint(s): Clinical variables: weight, height, BMI, waist and hip circumference and their ratio (incide CC), systolic arterial pressure (SAD), diastolic arterial pressure (DBP) and Tanner stage., Endocrine-metabolic variables: 1) insulinaemia [fasting glucose, insulin, HOMA-IR (5)]; 2) IGF-I; 3) gonadotropins (LH, FSH); 4) sex steroids [circulating androgens (total testosterone, androstenedione, SHBG, FAI) and oestradiol]; 5) lipids [total cholesterol, low-density lipoprotein (LDL), high-density lipoprotein (HDL), triglycerides]; 6) markers of inflammation, insulin sensitivity and brown adipose tissue activity [ultrasensitive C-reactive protein (usCRP), GDF-15, HMWadiponectin, CXCL14]., Safety markers: blood count, circulating levels of alanine transaminase (ALT), aspartate transaminase (AST), gamma-glutamyltransferase (GGT), thyroid stimulating hormone (TSH), urea, creatinine, electrolyte panel, vitamin B12, folic acid., Abdominal fat distribution (subcutaneous and visceral area) and liver fat: distribution of abdominal fat and intrahepatic fat shall be analysed by MRI., Additional secondary outcomes: 1) Dietary habits; 2) Tablet acceptability; 3) Adherence study; 4) Adverse events report.

Source: https://euclinicaltrials.eu/ctis-public/view/2024-518675-55-00